EU clinical trial 2023-505991-31-00: BIOMarkers in Endometrial Cancer - A phase III open label randomized trial to determine the efficacy of biomarker staging as compared to conventional staging in women with presumed early-stage endometrial cancer (The BIOMEC trial)
Protocol code: BIOMEC trial
Sponsor: Karolinska University Hospital (Hospital/Clinic/Other health care facility). Phase: Therapeutic confirmatory (Phase III). Countries: Sweden (ended).
Therapeutic area(s): Diseases [C] - Neoplasms [C04]
Gender: Female. Age: 18-64 years, 65+ years. Enrolment: 1037.
Status: Ended. Start date (EU): 2024-04-30. End date (EU): 2024-06-25. Decision date: 2023-09-29. Results received: Yes. Last updated: 2024-04-19.

Condition(s): ENDOMETRIAL CANCER
Product: PACLITAXEL, CARBOPLATIN

Primary endpoint: Overall survival
Endpoint(s): Recurrence-free survival, EORTC QLQ-C30, QLQ-EN24 and EQ5D-5L Score, LYMQOL and volume measurement, lymphosintigraphy result, Clinical Frailty Scale-9 score (1-9), As measured by CT and applicable software (e.g., Coreslicer, Slice-o-matic etc.), QALY, cost per patient, 30-day post-operative complications and adverse events

Source: https://euclinicaltrials.eu/ctis-public/view/2023-505991-31-00